EU clinical trial 2024-511565-11-00: HOVON 172 MF: A phase 1b/2 trial with tasquinimod in patients with myelofibrosis (primary, post-PV or post-ET) refractory to or intolerant for JAK2 inhibition: the TasqForce trial
Protocol code: HOVON 172 MF
Sponsor: Hemato-Oncologie voor Volwassenen Nederland (Hovon) Stichting (Hospital/Clinic/Other health care facility). Phase: Phase I and Phase II (Integrated)- Other. Countries: Germany (ongoing, recruiting), Netherlands (temporarily halted).
Therapeutic area(s): Diseases [C] - Neoplasms [C04]; Diseases [C] - Hemic and Lymphatic Diseases [C15]
Gender: Female, Male. Age: 18-64 years, 65+ years. Enrolment: 26.
Start date (EU): 2025-02-12. Decision date: 2024-10-22. Results received: No. Last updated: 2026-04-29.
Decision dates by country: NL: 2024-10-22, DE: 2024-10-23

Condition(s): Myelofibrosis
Product: Tasquinimod 0.5 mg, Tasquinimod 0.25 mg, Tasquinimod 1 mg

Primary endpoint: Phase 1b: Dose limiting toxicity (DLT), as defined in section 7.1 and recommended phase 2 dose level (RP2D), as defined in section 7.2, Phase 2: Proportion of participants with at least 35% reduction in spleen volume from baseline at Week 32 (SVR35W32) as measured by magnetic resonance imaging (MRI), per International Working Group (IWG) criteria, based on MRI review
Endpoint(s): Proportion of participants with at least 50% reduction in palpable splenomegaly from baseline per IWG criteria, Proportion of patients with at least 35% reduction in spleen volume from baseline (SVR35) as measured by MRI, per IWG criteria, based on MRI review, Overall survival, as defined from date of registration until date of death from any cause. Participants still alive at the date last contact, will be censored, Safety, as assessed by clinical, laboratory, and vital sign events; graded by the NCI CTCAE v5, Proportion of participants with at least 50% reduction in total symptom score (TSS) after 32 weeks from baseline as measured by MPN-SAF TSS, Reduction in grade of bone marrow fibrosis from baseline as measured by the European consensus grading system, Anemia response per IWG criteria, Red blood cell (RBC) transfusion (number of packed cells) during tasquinimod treatment, The effect of tasquinimod on the allelic burden of the driver mutations

Source: https://euclinicaltrials.eu/ctis-public/view/2024-511565-11-00